EU clinical trial 2024-516284-90-00: A prospective, controlled, randomized, double blind, 2-arms, parallel-group, multicentre, phase 3 study to investigate effectiveness of Actisoufre nasal spray in a pressurized container compared to placebo in female and male adult and paediatric population over 6 years old with acute rhinitis, rhinopharyngitis and rhinosinusitis not requiring antibiotic therapy.
Protocol code: ARG-01-2024
Sponsor: Laboratoires Grimberg (Pharmaceutical company). Phase: Therapeutic confirmatory (Phase III). Countries: Poland (authorised, recruitment pending).
Therapeutic area(s): Diseases [C] - Respiratory Tract Diseases [C08]
Gender: Female, Male. Age: 0-17 years, 18-64 years, 65+ years. Enrolment: 248.
Status: Authorised, recruitment pending. Decision date: 2025-09-08. Results received: No. Last updated: 2025-09-08.

Condition(s): rhinosinusitis not requiring antibiotic therapy, rhinopharyngitis not requiring antibiotic therapy, Acute rhinitis not requiring antibiotic therapy
Product: ACTISOUFRE, solution pour pulvérisation nasale/buccale en flacon pressurisé, Actisoufre Placebo

Primary endpoint: Change of the nasal symptoms (nasal obstruction, rhinorrhea (drip, sniff, snorting, drainage, discharge), thick mucus, sneezing, cough evaluated from baseline at Day 4 based on the specific “Common Cold Symptoms Severity Questionnaire” (CCSS), in the intervention group and in the control group. [Time points of CCSS assessment: Baseline (Day 1), Day 2, Day 3, Day 4, Day 8]
Endpoint(s): Change in the quality of sleep in the Actisoufre arm comparing to the placebo. [Time point: Baseline (Day 1), Day 2, Day 3, Day 4, Day 8], Change in patient’s Quality of Life based on the VAS scale [Time point: Baseline (Day 1), Day 4, Day 8], Evaluation of onset of immediate relief after the entire product application is completed at Day 1 (baseline) and once daily up to Day 4 of the study. [Time point: Baseline, Day 2, Day 3, Day 4], Number of subjects with a need of use of nasal decongestants as an emergency treatment. [Time point: Day 8], Assessment of use of concomitant medications (including frequency) from baseline to the end of the study. [Time point: Baseline, Day 4, Day 8], Number of Adverse Events and Serious Adverse Events in intervention group comparing to the control group. [Time point: Baseline, Day 4, Day 8]

Source: https://euclinicaltrials.eu/ctis-public/view/2024-516284-90-00